EU clinical trial 2025-521911-38-00: An open-label, multi-center, phase I/II study of GVV858 as a single agent and in combination with endocrine therapy in patients with advanced hormone receptor positive, HER2-negative breast cancer and other advanced solid tumors
Protocol code: CGVV858A12101
Sponsor: Novartis Pharma AG (Pharmaceutical company). Phase: Phase I and Phase II (Integrated)- First administration to humans. Countries: Italy (ongoing, recruiting), Germany (ongoing, recruiting), France (authorised, recruitment pending), Czechia (authorised, recruitment pending), Denmark (ongoing, recruiting), Spain (authorised, recruitment pending).
Therapeutic area(s): Diseases [C] - Neoplasms [C04]
Gender: Female, Male. Age: 18-64 years, 65+ years. Enrolment: 55.
Start date (EU): 2026-05-26. Decision date: 2026-04-16. Results received: No. Last updated: 2026-05-22.
Decision dates by country: CZ: 2026-04-16, DK: 2026-04-21, DE: 2026-04-17, IT: 2026-04-22, ES: 2026-04-20, FR: 2026-04-17

Condition(s): Advanced HR+/HER- breast cancer
Product: LEUPRORELIN ACETATE, LETROZOLE, GVV858, LEUPRORELIN ACETATE, FULVESTRANT, GVV858, GOSERELIN, GOSERELIN

Primary endpoint: Phase I: Safety: Incidence and severity of dose-limiting toxicities (DLTs), adverse events (AEs) and serious adverse events (SAEs), including changes in lab values, vital signs, electrocardiograms (ECGs). Tolerability: Frequency of dose interruptions, reductions, discontinuations, dose intensity., Phase II: Safety: Incidence and severity of adverse events (AEs) and serious adverse events (SAEs), including changes in lab values, vital signs, electrocardiograms (ECGs). Tolerability: Frequency of dose interruptions, reductions, discontinuations, dose intensity.
Endpoint(s): Phase II: ORR, BOR, DCR, CBR, PFS and duration of response (DOR) per investigator assessment of RECIST v1.1. Plasma concentrations of GVV858 and derived PK parameters (e.g., AUC, Tmax, and Cmax)., Phase I: Plasma concentrations of GVV858 and derived PK parameters (e.g., AUC, Tmax, Cmax). ORR, BOR, DCR, CBR, and PFS per investigator assessment of response evaluation criteria in solid tumors (RECIST v1.1), or local PCWG3 criteria including PCWG3-modified RECIST v1.1 (prostate cancer patients only).

Source: https://euclinicaltrials.eu/ctis-public/view/2025-521911-38-00